EU clinical trial 2022-500930-27-00: A Phase 1 Study of BMS-986360/CC-90001 Alone and in Combination with Chemotherapy or Nivolumab in Advanced Solid Tumors
Protocol code: IM043-004
Sponsor: Celgene Corp. (Pharmaceutical company). Phase: Human Pharmacology (Phase I)- Other. Countries: Italy (ended), Spain (ended), France (ended).
Therapeutic area(s): Diseases [C] - Neoplasms [C04]
Gender: Female, Male. Age: 18-64 years, 65+ years. Enrolment: 48.
Status: Ended. Start date (EU): 2023-09-15. End date (EU): 2025-05-12. End date: 2025-05-13. Decision date: 2023-07-11. Results received: No. Last updated: 2025-02-06.
Decision dates by country: FR: 2023-07-17, ES: 2023-07-11, IT: 2023-07-13

Condition(s): Solid Tumor

Source: https://euclinicaltrials.eu/ctis-public/view/2022-500930-27-00